EU clinical trial 2025-522181-71-00: A Study to Investigate the Effect of RO7504109 on Immune Cells in Healthy Participants
Protocol code: BP45669
Sponsor: F. Hoffmann-La Roche AG (Pharmaceutical company). Phase: Human Pharmacology (Phase I)- Other. Countries: Netherlands (ended).
Therapeutic area(s): Health Care [N] - Population Characteristics [N01]
Gender: Female, Male. Age: 18-64 years. Enrolment: 44.
Status: Ended. Start date (EU): 2025-09-17. End date (EU): 2026-02-24. End date: 2026-02-27. Decision date: 2025-09-16. Results received: No. Last updated: 2025-09-16.

Condition(s): Not Applicable (N/A)

Source: https://euclinicaltrials.eu/ctis-public/view/2025-522181-71-00